EU clinical trial 2023-505846-24-00: VEN-R DASA-IPC 2022-067 Evaluation of DASATINIB monotherapy in acute myeloid leukemia patients refractory to VENETOCLAX-AZACITIDINE
Protocol code: IPC 2022-067
Sponsor: Institut Paoli-Calmettes (Hospital/Clinic/Other health care facility). Phase: Therapeutic exploratory (Phase II). Countries: France (temporarily halted).
Therapeutic area(s): Diseases [C] - Neoplasms [C04]
Gender: Female, Male. Age: 18-64 years, 65+ years. Enrolment: 45.
Status: Temporarily halted. Start date (EU): 2024-04-08. Decision date: 2023-12-08. Results received: No. Last updated: 2023-12-08.

Condition(s): acute myeloid leukemia
Product: DASATINIB VIATRIS 50 mg, comprimé pelliculé, DASATINIB VIATRIS 70 mg, comprimé pelliculé

Primary endpoint: Objective response rate after 2 cycles of 28 days DASATINIB defined as the rate of complete remission (CR) or complete remission with incomplete hematologic recovery (CRi) according to ELN 2022 criteria.
Endpoint(s): Different response rates (RC, CRi, or partial remission (PR)) according to ELN 2022 criteria., Blast clearance rate (morphologic leukemia free state, MLFS) according to ELN 2022 criteria, Time to response (time between the start of the treatment until achievement of the CR, CRi or PR), Duration of relapse-free period (time between the response time and the relapse), Event-free survival (EFS, time between start of treatment and relapse, no reponse or death), Overall survival (duration of survival from the start of the treatment), Occurrence of Adverse Events according to CTCAE v5.0 and Serious Adverse Reaction

Source: https://euclinicaltrials.eu/ctis-public/view/2023-505846-24-00